EU clinical trial 2024-512091-35-01: Low dose ColchicinE in pAtients with peripheral artery DiseasE to address residual vascular Risk: A randomized trial- LEADER PAD
Sponsor: Hamilton Health Sciences Corporation (Hospital/Clinic/Other health care facility). Phase: Therapeutic confirmatory (Phase III). Countries: Italy (authorised, recruitment pending), Belgium (ongoing, recruiting), Netherlands (ongoing, recruiting), Germany (authorised, recruitment pending).
Therapeutic area(s): Diseases [C] - Cardiovascular Diseases [C14]
Gender: Female, Male. Age: 18-64 years, 65+ years. Enrolment: 1898.
Start date (EU): 2025-06-17. Decision date: 2025-02-26. Results received: No. Last updated: 2026-06-30.
Decision dates by country: BE: 2025-02-27, IT: 2025-02-26, NL: 2025-06-05, DE: 2026-03-24

Condition(s): Peripheral arterial disease
Product: Colchicine Tiofarma 500 microgram Tablets, Placebo matching Tiofarma colchicine 500 mcg tablets

Primary endpoint: Rate of major adverse cardiovascular and limb events (MACE or MALE). This composite outcome consists of cardiovascular deaths, myocardial infarction, stroke, and severe limb ischemia that requires a vascular intervention (i.e., pharmacological reperfusion, endovascular or surgical revascularization) or a major vascular amputation (defined as ankle/transtibial amputation or higher).
Endpoint(s): Extended MALE; This composite outcome includes major adverse limb events (MALE) as well as revascularization for new or worsening claudication of new stenosis or occlusion detected on screening after a previous intervention, Cardiovascular death, Myocardial infarction, Stroke, Hospitalization, Acute or chronic limb-threatening ischemia, All revascularization (coronary or cerebrovascular or lower limb or other peripheral revascularization), Total vascular amputation, Overall mortality, Any thrombosis or thromboembolism (arterial and venous), Fontaine Stage, Standard Assessment of Global Everyday Activities (SAGEA), Vascular Quality of Life Questionnaire-6 (VascQOL-6), EuroQol 5 Dimension 5 Level (EQ-5D-5L)

Source: https://euclinicaltrials.eu/ctis-public/view/2024-512091-35-01